EU clinical trial 2023-510166-27-01: Prospective comparison of sirolimus against corticosteroids in treatment of patients with active thyroid eye disease
Sponsor: Helse Bergen HF (Hospital/Clinic/Other health care facility). Phase: Therapeutic confirmatory (Phase III). Countries: Norway (ongoing, recruiting).
Therapeutic area(s): Diseases [C] - Eye Diseases [C11]
Gender: Female, Male. Age: 18-64 years, 65+ years. Enrolment: 70.
Status: Ongoing, recruiting. Start date (EU): 2024-06-22. Decision date: 2024-06-21. Results received: No. Last updated: 2026-03-03.

Condition(s): Thyroid eye disease
Product: Rapamune 0.5 mg coated tablets, Solu-Medrol S.A.B. (Sine Alcohol Benzylicus) 500 mg Pulver und Lösungsmittel zur Herstellung einer Injektionslösung Methylprednisolon

Primary endpoint: ≥2 point reduction in Clinical Activity Score (CAS) from baseline at week 12.
Endpoint(s): ≥ 2 mm reduction from baseline in proptosis in one eye at week 12., ≥ 2 mm reduction from baseline in vertical lid aperture in one eye at week 12., ≥ 1 class improvement of eye motility from baseline assessed by Gorman score at week 12., Gorman score: 1 = no diplopia, 2 intermittent diplopia, 3 = inconstant (gaze-evoked) diplopia, 4 = constant diplopia in primary or reading position, ≥ 6 points improvement in GO-QOL score

Source: https://euclinicaltrials.eu/ctis-public/view/2023-510166-27-01